EU clinical trial 2024-519497-39-00: A phase 2a multi-site, randomized, double-blind, dose escalated, placebo-controlled biomarker study to determine the safety, tolerability and biomarker-based efficacy of NPI-001 (AT-001) in subjects with MCI (Mild Cognitive Impairment) or mild dementia due to Alzheimer’s disease (AD) aged 50 to 85 years
Protocol code: AT-24-03
Sponsor: Arctic Therapeutics ehf. (Pharmaceutical company). Phase: Therapeutic exploratory (Phase II). Countries: Denmark (ongoing, recruitment ended), Iceland (ongoing, recruitment ended).
Therapeutic area(s): Diseases [C] - Nervous System Diseases [C10]
Gender: Female, Male. Age: 18-64 years, 65+ years. Enrolment: 30.
Status: Ongoing, recruitment ended. Start date (EU): 2025-10-03. Decision date: 2025-05-05. Results received: No. Last updated: 2026-06-26.
Decision dates by country: IS: 2025-05-12, DK: 2025-07-15

Condition(s): Alzheimer's Disease
Product: Placebo white oral tablet with lactose, micro-crystalline cellulose, croscarmellose sodium and stearic acid as excipients.

Primary endpoint: • Treatment-Emergent Adverse Events and Serious Adverse Events., clinical lab values, electrocardiogram, physical examination, vital signs. ARIA MRI classification
Endpoint(s): • Reduction in toxic amyloid oligomers in plasma samples at 3, 6, 9 and 12 months of therapy., • Reduction in amyloid accumulation in the brain following 12 months of therapy., • Reduction in pTau217 and pTau217/tTau ratio in plasma samples at 3, 6, 9 and 12 months of therapy., • Reduction in NFL in plasma samples at 3, 6, 9 and 12 months of therapy., • Neuropsychological Test Battery (NTB), Change in Clinical Dementia Rating (CDR) Scale, ADAScog and ADL (ADCS-ADL-MCI) following 12 months of therapy., • Plasma concentrations of NPI-001 will be measured after the first intake of NPI-001 and after 12 months of intake on eight occasions up to 24hr., • The following PK parameters will be determined: Cmax, Tmax and AUC0-24h.apparent T1/2, • Change from baseline in Clinical Dementia Rating (CDR) Scale, ADAS-Cog, Columbia Suicide Severity Rating Scale (C-SSRS) following 12 months of therapy

Source: https://euclinicaltrials.eu/ctis-public/view/2024-519497-39-00